EU clinical trial 2024-510744-31-00: A randomized, parallel-group, double-blind, placebo-controlled, multicenter Phase III trial to investigate the efficacy and safety of secukinumab 300 mg and 150 mg administered subcutaneously versus placebo, in combination with a glucocorticoid taper regimen, in patients with giant cell arteritis (GCA) (GCAptAIN)
Protocol code: CAIN457R12301
Sponsor: Novartis Pharma AG (Pharmaceutical company). Phase: Therapeutic confirmatory (Phase III). Countries: Estonia (ended), Sweden (ended), Hungary (ended), Finland (ended), France (ended), Norway (ended), Greece (ended), Czechia (ended), Portugal (ended), Italy (ended), Poland (ended), Belgium (ended), Germany (ended), Bulgaria (ended), Austria (ended), Denmark (ended), Spain (ended).
Therapeutic area(s): Diseases [C] - Immune System Diseases [C20]
Gender: Female, Male. Age: 18-64 years, 65+ years. Enrolment: 243.
Status: Ended. Start date (EU): 2021-10-06. End date (EU): 2026-02-06. End date: 2026-02-18. Decision date: 2024-07-17. Results received: No. Last updated: 2025-12-11.
Decision dates by country: FI: 2024-07-18, BG: 2024-08-06, ES: 2024-07-17, SE: 2024-07-22, CZ: 2024-07-22, HU: 2024-07-17, PT: 2024-07-17, PL: 2024-08-04, FR: 2024-08-14, IT: 2024-07-24, GR: 2024-07-22, EE: 2024-07-19, AT: 2024-07-22, BE: 2024-07-19, NO: 2024-07-18, DK: 2024-07-22, DE: 2024-07-19

Condition(s): Giant cell arteritis (GCA)
Product: PREDNISONE, Placebo to AIN457 150mg/1mL solution for injection in pre-filled syringe, SECUKINUMAB, PREDNISONE, Placebo to Prednisone 1 mg, 2.5mg, 5mg, 20mg hard gelatin capsule with tablet content, PREDNISONE, PREDNISONE, SECUKINUMAB, Placebo to AIN457 300mg/2mL solution for injection in pre-filled syringe

Primary endpoint: Sustained remission at Week 52 as per definition of sustained remission in the protocol.
Endpoint(s): Time to clinical failure as measured in days through Week 52 per definition of clinical failure in the protocol., Cumulative GC dose through Week 52, Sustained remission at Week 52, Time to clinical failure as measured in days through Week 52, Change in SF-36 score (PCS) at Week 52, Change in Glucocorticoid Toxicity Index (GTI) as measured by the Aggregate Improvement Score (AIS) at Week 52, Change in FACIT-Fatigue score at Week 52, Safety and tolerability demonstrated by assessing: Adverse events (AEs) and serious adverse events (SAEs) (incidence, severity, and relationship to study drug) Changes in laboratory measures and vital signs

Source: https://euclinicaltrials.eu/ctis-public/view/2024-510744-31-00